EU clinical trial 2024-517711-70-01: A Randomized, Double-Blinded, Placebo-Controlled, Dose-Finding, Adaptive Trial to Evaluate the Safety, Tolerability, and Efficacy of TAK-360 in Participants with Narcolepsy without Cataplexy (NT2)
Protocol code: TAK-360-2001
Sponsor: Takeda Development Center Americas Inc. (Pharmaceutical company). Phase: Therapeutic exploratory (Phase II). Countries: Spain (ongoing, recruiting), Italy (ongoing, recruiting), France (ongoing, recruiting).
Therapeutic area(s): Diseases [C] - Nervous System Diseases [C10]
Gender: Female, Male. Age: 18-64 years, 65+ years. Enrolment: 43.
Status: Ongoing, recruiting. Start date (EU): 2025-12-04. Decision date: 2025-11-14. Results received: No. Last updated: 2026-07-10.
Decision dates by country: FR: 2025-11-14, IT: 2025-11-14, ES: 2025-11-17

Condition(s): Narcolepsy without Cataplexy (NT2)

Primary endpoint: Occurrence of at least 1 (TEAE) during the trial.
Endpoint(s): 1. Change from baseline at Week4 in ESS total score, as compared with placebo., 2. Change from baseline at Week 4 in mean sleep latency on the MWT, as compared with placebo.

Source: https://euclinicaltrials.eu/ctis-public/view/2024-517711-70-01